EU clinical trial 2026-526531-18-00: Perioperative Intravenous Metamizole in Laparoscopic Cholecystectomy: A rondomized, double blind, clinical trial.
Sponsor: UZ Leuven (Hospital/Clinic/Other health care facility). Phase: Phase III and phase IV (Integrated). Countries: Belgium (authorised, recruitment pending).
Therapeutic area(s): Analytical, Diagnostic and Therapeutic Techniques and Equipment [E] - Anesthesia and Analgesia [E03]
Gender: Female, Male. Age: 18-64 years, 65+ years. Enrolment: 76.
Status: Authorised, recruitment pending. Decision date: 2026-07-31. Results received: No. Last updated: 2026-07-31.

Condition(s): Post operative pain relief in Patients undergoing laparoscopic cystectomy in day-surgery clinic
Product: NOVALGINE I.M./I.V. 1000 mg/2 ml solution injectable, MINI-PLASCO NACL B. BRAUN 0,9 %, oplossing voor injectie

Primary endpoint: The primary endpoint is the opioid consumption in IV morphine milligram equivalents (MME) administered peroperatively and during the first 3 postoperative hours.
Endpoint(s): Mean NRS (evaluated every 15 minutes until 60’ postoperative (+0’ +15’, +30’, +45’, +60’)), Number of given doses of rescue analgesia on PACU, Mean NRS hourly after PACU stay until discharge, Time to first rescue analgesia in PACU, Time to be ready for discharge from hospital Day Care Unit, Opioid consumption until discharge (IV morphine equivalents), Analgesic consumption (0-48h postoperative), Aldrete score (evaluated every 15, during PACU stay), PADSS (every hour from admission to Day Care Unit until discharge from hospital), QoR-15 POD1 and POD2

Source: https://euclinicaltrials.eu/ctis-public/view/2026-526531-18-00